EU clinical trial 2022-502046-28-00: A Phase III, Multicenter, Randomized, Double-Blind, Placebo-Controlled Study Evaluating the Efficacy and Safety of Inavolisib in Combination with Phesgo® Versus Placebo in Combination with Phesgo® as Maintenance Therapy After First Line Induction Therapy in Participants with PIK3CA‑Mutated HER2‑Positive Locally Advanced or Metastatic Breast Cancer
Protocol code: WO44263
Sponsor: F. Hoffmann-La Roche AG (Pharmaceutical company). Phase: Therapeutic confirmatory (Phase III). Countries: Poland (ongoing, recruiting), Spain (ongoing, recruiting), France (ongoing, recruiting), Belgium (ongoing, recruiting), Italy (ongoing, recruiting), Germany (ongoing, recruiting), Finland (ended).
Therapeutic area(s): Health Care [N] - Environment and Public Health [N06]; Diseases [C] - Neoplasms [C04]
Gender: Female, Male. Age: 18-64 years, 65+ years. Enrolment: 67.
Start date (EU): 2023-12-22. Decision date: 2023-06-29. Results received: No. Last updated: 2026-06-23.
Decision dates by country: FI: 2023-07-11, BE: 2023-06-29, DE: 2023-06-29, PL: 2023-07-10, IT: 2023-07-03, FR: 2023-07-05, ES: 2023-07-03

Condition(s): HER2-Positive, PIK3CA Mutated, Locally Advanced or Metastatic Breast Cancer
Product: TAMOXIFEN, PACLITAXEL ALBUMIN-BOUND, INAVOLISIB, GOSERELIN ACETATE, Phesgo 600 mg/600 mg solution for injection, Inavolisib Placebo, EXEMESTANE, ANASTROZOLE, INAVOLISIB, Phesgo 1200 mg/600 mg solution for injection, PACLITAXEL, INAVOLISIB, LETROZOLE, ANHYDROUS DOCETAXEL

Primary endpoint: 1. Investigator assessed progression-free survival (PFS)
Endpoint(s): Overall survival (OS), Objective Response Rate (ORR), Duration of Response (DOR), Clinical Benefit Rate (CBR), Progression-free survival 2 (PFS 2), Mean and mean changes from baseline score in function and HRQoL by cycle and between treatment arms as assessed through the use of the Functional (Role, Physical) and GHS/QoL scales of the EORTC QLQ-C30, Incidence and severity of adverse events, with severity determined according to the National Cancer Institute Common Terminology Criteria for Adverse Events Version 5.0 (NCI CTCAE v5.0) grading scale, Change from baseline in targeted clinical laboratory test results, Plasma concentration of inavolisib at specified timepoints

Source: https://euclinicaltrials.eu/ctis-public/view/2022-502046-28-00